EU clinical trial 2024-516753-45-00: SETmelanotide to improve hypothalamic function in the ROHHAD-syndrome; a proof of concept study in a small mono-center cohort: the ROH-SET Study
Sponsor: Universitair Medisch Centrum Utrecht (Hospital/Clinic/Other health care facility). Phase: Therapeutic exploratory (Phase II). Countries: Netherlands (ongoing, recruiting).
Therapeutic area(s): Diseases [C] - Hormonal diseases [C19]
Gender: Female, Male. Age: 0-17 years, 18-64 years. Enrolment: 5.
Status: Ongoing, recruiting. Start date (EU): 2025-04-25. Decision date: 2025-03-06. Results received: No. Last updated: 2025-03-06.

Condition(s): ROHHAD syndrome
Product: IMCIVREE 10 mg/ml solution for injection

Primary endpoint: Change in overall scores for signs and symptoms of hypothalamic dysfunction after 16 weeks, 32 weeks and 52 weeks
Endpoint(s): BMI SDS after 16 weeks, 32 weeks and 52 weeks, % fat free mass after 16 weeks, 32 weeks and 52 weeks (measured by BIA), Waist circumference after 16 weeks, 32 weeks and 52 weeks, Presence of liver steatosis after 16 weeks, 32 weeks and 52 weeks, Hyperphagia scores (Hyperphagia Questionnaire for Clinical Trials (HQ-CT) Dutch-NL) after 16 weeks, 32 weeks and 52 weeks, Stability of temperature (diary entries) after 16 weeks, 32 weeks and 52 weeks, Respiratory insufficiency after 16 weeks, 32 weeks and 52 weeks, Circadian rhythm: Mean sleeping scores (7 days, measured by actigraphy) and PROMIS sleep disturbance scores after 16 weeks, 32 weeks and 52 weeks, Level of activity after 16 weeks, 32 weeks and 52 weeks (actigraphy: mean steps in 7 days, PAQ-A/PAQ-C questionnaire), Resting energy expenditure (REE) (in children age >6 years) after 52 weeks, Change in the other symptoms of autonomous dysregulation after 16 weeks, 32 weeks and 52 weeks as described in Tabel 2, Quality of live (PedsQL questionnaire scores) after 16 weeks, 32 weeks and 52 weeks, The difference in cardiometabolic parameters including blood pressure, lipid profile, HbA1c, liver enzymes after 52 weeks, Percentage of patients with adverse events such as skin hyperpigmentation, injection site reaction, nausea, headache (clinical evaluation), Any serious adverse events or other adverse events, Change in AVP deficiency management (desmopressin dosage, need for home sodium measurements, hypo/hypernatremia) after 16 weeks, 32 weeks, 52 weeks

Source: https://euclinicaltrials.eu/ctis-public/view/2024-516753-45-00